EU clinical trial 2024-511411-25-00: Phase 3 Follow-up Study of AAV5-hRKp.RPGR for the Treatment of X-linked Retinitis Pigmentosa Associated with Variants in the RPGR gene
Protocol code: MGT-RPGR-022
Sponsor: Janssen Cilag International (Pharmaceutical company). Phase: Therapeutic confirmatory (Phase III). Countries: Italy (ongoing, recruitment ended), France (ongoing, recruitment ended), Spain (ongoing, recruitment ended), Netherlands (ongoing, recruitment ended), Denmark (ongoing, recruitment ended), Belgium (ongoing, recruitment ended).
Therapeutic area(s): Diseases [C] - Eye Diseases [C11]
Gender: Female, Male. Age: 0-17 years, 18-64 years. Enrolment: 31.
Status: Ongoing, recruitment ended. Start date (EU): 2022-08-25. Decision date: 2024-06-21. Results received: No. Last updated: 2026-07-09.
Decision dates by country: FR: 2024-06-27, DK: 2024-06-21, ES: 2024-06-21, BE: 2024-06-21, IT: 2024-07-31, NL: 2024-06-21

Condition(s): X-Linked Retinitis Pigmentosa caused by mutations in the RPGR gene
Product: VANCOMYCIN, CEFAZOLIN, BETAMETHASONE, CEFUROXIME, JNJ-74765340, TRIAMCINOLONE, DEXAMETHASONE, JNJ-74765340, OMEPRAZOLE

Primary endpoint: 1. Adverse events 2. Laboratory assessments 3. Change from baseline in best corrected visual acuity (BCVA) by Early Treatment Diabetic Retinopathy Study (ETDRS) chart letter score in monocular assessment 4. Change from baseline in low luminance visual acuity (LLVA) by ETDRS chart letter score in monocular assessment

Source: https://euclinicaltrials.eu/ctis-public/view/2024-511411-25-00